EU clinical trial 2023-510230-84-00: A 52-week, randomised, double-blind, double-dummy, parallel group, multi-centre, non-inferiority study assessing exacerbation rate, additional measures of asthma control and safety in adult and adolescent severe asthmatic participants with an eosinophilic phenotype treated with GSK3511294 (depemokimab) compared with mepolizumab or benralizumab
Protocol code: 206785
Sponsor: Glaxosmithkline Research & Development Limited (Pharmaceutical company). Phase: Therapeutic confirmatory (Phase III). Countries: Slovenia (ended), Netherlands (ended), Portugal (ended), Italy (ended), France (ended), Sweden (ended), Finland (ended), Norway (ended), Spain (ended), Germany (ended), Ireland (ended), Austria (ended).
Therapeutic area(s): Diseases [C] - Respiratory Tract Diseases [C08]
Gender: Female, Male. Age: 0-17 years, 18-64 years, 65+ years. Enrolment: 750.
Status: Ended. Start date (EU): 2021-05-28. End date (EU): 2025-09-10. End date: 2025-09-14. Decision date: 2024-06-19. Results received: Yes. Last updated: 2025-10-27.
Decision dates by country: NL: 2024-06-19, NO: 2024-06-25, IE: 2024-06-19, FI: 2024-06-20, SI: 2024-06-28, AT: 2024-06-24, ES: 2024-06-24, PT: 2024-06-19, SE: 2024-06-20, DE: 2024-06-25, FR: 2024-06-24, IT: 2024-07-09

Condition(s): Severe asthma with an eosinophilic phenotype
Product: A placebo matching Mepolizumab, Nucala 100 mg solution for injection in pre-filled syringe, A placebo matching Depemokimab, GSK3511294, Placebo for benralizumab for clinical trials is a sterile liquid solution presented in an accessorized prefilled syringe (apfs) for subcutaneous injection, Nucala 100 mg solution for injection in pre-filled syringe, Fasenra 30 mg solution for injection in pre-filled syringe

Primary endpoint: Annualised rate of clinically significant exacerbations over 52 weeks
Endpoint(s): Weighted mean change from baseline in St. George's Respiratory Questionnaire (SGRQ) total score calculated over 52 weeks, Weighted mean change from baseline in Asthma Control Questionnaire-5 (ACQ-5) score calculated over 52 weeks, Weighted mean change from baseline in pre-bronchodilator forced expiratory volume in one second (FEV1) calculated over 52 weeks

Source: https://euclinicaltrials.eu/ctis-public/view/2023-510230-84-00